EU clinical trial 2026-526304-79-00: A Phase III, Randomized, Double-blind, Parallel-group, Placebo controlled, Multicenter Study to Evaluate the Effect of Elecoglipron in Reducing Cardiovascular Outcomes in Participants with HFpEF and HFmrEF (Elevate-HF)
Protocol code: D7266C00001
Sponsor: AstraZeneca AB (Pharmaceutical company). Phase: Therapeutic confirmatory (Phase III). Countries: Spain (authorised, recruitment pending), Hungary (authorised, recruitment pending), Germany (authorised, recruitment pending), Poland (authorised, recruitment pending), Italy (authorised, recruitment pending), Bulgaria (authorised, recruitment pending), Netherlands (authorised, recruitment pending), Austria (authorised, recruitment pending), Romania (authorised, recruitment pending), Sweden (authorised, recruitment pending), France (authorised, recruitment pending), Greece (authorised, recruitment pending), Slovakia (authorised, recruitment pending), Czechia (authorised, recruitment pending).
Therapeutic area(s): Diseases [C] - Cardiovascular Diseases [C14]
Gender: Female, Male. Age: 18-64 years, 65+ years. Enrolment: 2343.
Status: Authorised, recruitment pending. Decision date: 2026-07-29. Results received: No. Last updated: 2026-08-07.
Decision dates by country: AT: 2026-08-02, BG: 2026-07-31, CZ: 2026-07-30, FR: 2026-08-03, DE: 2026-07-30, GR: 2026-07-30, HU: 2026-08-03, IT: 2026-07-31, RO: 2026-08-03, ES: 2026-08-03, SE: 2026-07-31, NL: 2026-08-03, PL: 2026-08-03, SK: 2026-07-29

Condition(s): Heart failure with preserved ejection fraction (HFpEF) and heart failure with mildly reduced ejection fraction (HFmrEF); on background SGLT2i.
Product: Placebo for Elecoglipron (AZD5004), Elecoglipron, Elecoglipron, Elecoglipron, Elecoglipron, Forxiga 10 mg film-coated tablets

Primary endpoint: Time to first occurrence of any component of the composite of cardiovascular (CV) death, hospitalization for heart failure (HHF), or urgent heart failure (HF) visit.
Endpoint(s): 1. Total number of HF events (first and recurrent; HHF and urgent HF visit)., 2. Change from baseline to Week 52 in a prespecified heart failure patient‑reported outcome total score among participants with baseline value below a prespecified threshold., 3. Time to first occurrence of composite of all cause death, HHF, myocardial infarction (MI), or stroke (4point MACE).

Source: https://euclinicaltrials.eu/ctis-public/view/2026-526304-79-00